EU clinical trial 2024-513890-30-00: SePkLin Study: Pragmatic, Multicenter, Randomized, Controlled Clinical Trial in Patients with Sepsis to Evaluate the Safety and Efficacy of Personalized Pk/Pd Dosing Versus Standard Dosing of LINezolid.
Protocol code: SePkLIN
Sponsor: Fundacion Instituto De Investigacion Sanitaria De Santiago De Compostela (Patient organisation/association). Phase: Therapeutic use (Phase IV). Countries: Spain (ended).
Therapeutic area(s): Diseases [C] - Bacterial Infections and Mycoses [C01]
Gender: Female, Male. Age: 18-64 years, 65+ years. Enrolment: 692.
Status: Ended. End date (EU): 2026-03-04. Decision date: 2024-08-02. Results received: No. Last updated: 2024-08-02.

Condition(s): Sepsis
Product: LINEZOLID, LINEZOLID

Primary endpoint: Incidence of thrombocytopenia. Thrombopenia will be considered to be a platelet count below 75% of the patient's baseline value, at any time during the follow-up period.
Endpoint(s): Recurrence rate (relapses and reinfections) up to day 28: Recurrence is defined as the reappearance of symptoms of infection together with a positive culture for the same microorganism isolated in the initial culture in a patient with clinical cure at the cure visit. Reinfection is defined in a similar way, but with isolation of a different strain from the initial one., Mortality: mortality from all causes will be evaluated at 14 and 28 days., Changes in the SOFA scale: evolution of the daily values in the SOFA scale., Duration of admission to the critical care unit: number of days from admission to the critical care unit until being discharged from the unit., Days free from treatment with vasopressor agents: number of days that the patient avoided receiving vasopressor agents., Days free from mechanical ventilation: number of days that the patient avoided mechanical ventilation., Renal Replacement Therapy Free Days: Number of days the patient avoided renal replacement therapy., Days free of extracorporeal therapy: number of days that the patient avoided the use of extracorporeal membrane oxygenation., Percentage of patients in therapeutic range: the percentage of patients in therapeutic range will be evaluated, 2-7 mg/L, Percentage of patients achieving the target PK/PD parameter: the percentage of patients achieving the target PK/PD parameter of AUC0 →24h/MIC ≥100 and %T>MIC will be evaluated. When microbiological culture and its corresponding MIC are not available, the ECOFF value defined by EUCAST will be used.

Source: https://euclinicaltrials.eu/ctis-public/view/2024-513890-30-00